EU clinical trial 2024-514419-93-00: An open label study followed by a randomised, double-blind, placebo-controlled, parallel group and an extension study to investigate the safety and efficacy of GB1211 (a galectin-3 inhibitor) in combination with atezolizumab in patients with Non-Small Cell Lung Cancer (NSCLC).
Protocol code: GALLANT-1
Sponsor: Galecto Biotech AB (Pharmaceutical company). Phase: Phase I and Phase II (Integrated)- Other. Countries: France (ended), Spain (ended).
Therapeutic area(s): Diseases [C] - Neoplasms [C04]
Gender: Female, Male. Age: 18-64 years, 65+ years. Enrolment: 49.
Status: Ended. Start date (EU): 2022-05-19. End date (EU): 2025-11-20. Decision date: 2024-11-04. Results received: Yes. Last updated: 2025-03-05.
Decision dates by country: FR: 2024-11-14, ES: 2024-11-04

Condition(s): Study to investigate the safety and efficacy of GB1211 (a galectin-3 inhibitor) in combination with atezolizumab in patients with Non-Small Cell Lung Cancer (NSCLC)., Study to investigate the safety and efficacy of GB1211 (a galectin-3 inhibitor) in combination with atezolizumab in patients with Non-Small Cell Lung Cancer (NSCLC).
Product: 5-Bromopyridin-3-yl 3-deoxy-1-thio-3-[4-(3,4,5-trifluorophenyl)-1H-1,2,3-triazol-1-yl]-alfa-D-galactopyranoside, placebo to GB1211 capsules, Tecentriq 1 200 mg concentrate for solution for infusion

Primary endpoint: Part A: number of AEs in the 200 mg group compared to number of AEs in the dosing group (s)., Part B: number of AEs with GB1211 and atezolizumab compared to placebo and atezolizumab. The incidence, frequency and severity of AEs, SAEs, treatment related AEs, immune-related AEs, Grade 3 and above AEs and AEs leading to GB1211 discontinuation or study withdrawal. The incidence and frequency of laboratory parameter abnormalities., Part B: The percentage change from baseline in the sum of longest diameters of target lesions at Week 12, %ΔTSWk12, based on ICR according to RECIST 1.1., Part C: The number of AEs with GB1211 and atezolizumab compared to placebo and atezolizumab. The incidence, frequency and severity of AEs, SAEs, treatment related AEs, immune-related AEs, Grade 3 and above AEs and AEs leading to GB1211 discontinuation or study withdrawal.
Endpoint(s): Part A: The recommended tolerable dose of GB1211 in combination with atezolizumab determined by assessment of SAEs, treatment related AEs, immune-related AEs, Grade 3 and above AEs and AEs leading to GB1211 discontinuation or study withdrawal in the sentinel groups., Part A and B: Clinical effects in accordance with RECIST v1.1: o ORR based on Local Tumour Assessment (LTA) (Part A) and ICR (Part B). o DoR and TTR. o TTP is defined as the time from randomisation until objective tumour progression. TTP does not include deaths. o Disease Control defined as patients with a response or stable disease, assessed at each imaging assessment from randomisation to progression or death due to any cause, whichever occurs first., Part A and B: Plasma concentrations of GB1211 and derived pharmacokinetic parameters including Cmax, Tmax, AUC and others, as appropriate., Part C: ORR (CR and PR), clinical benefit (CR, PR and SD), DoR and PFS. Time to PR or CR for those patients who enter the study with SD as best response. PFS is defined as the time from the first dose until the first documentation of disease progression or death due to any cause, whichever occurs first.

Source: https://euclinicaltrials.eu/ctis-public/view/2024-514419-93-00